EU clinical trial 2024-519304-28-00: A randomized, Phase 3, open-label study to investigate pharmacokinetics, safety, and efficacy of subcutaneous compared to intravenous frexalimab in adult participants with multiple sclerosis.
Protocol code: EFC18098
Sponsor: Sanofi-Aventis Recherche & Developpement (Pharmaceutical company). Phase: Therapeutic confirmatory (Phase III). Countries: Belgium (ongoing, recruiting), Spain (ongoing, recruiting), Italy (ongoing, recruiting).
Therapeutic area(s): Diseases [C] - Nervous System Diseases [C10]
Gender: Female, Male. Age: 18-64 years. Enrolment: 67.
Status: Ongoing, recruiting. Start date (EU): 2026-04-20. Decision date: 2026-04-08. Results received: No. Last updated: 2026-06-18.
Decision dates by country: BE: 2026-04-08, IT: 2026-04-10, ES: 2026-04-13

Condition(s): Multiple Sclerosis
Product: Frexalimab

Primary endpoint: Area under the curve over the interval W20 to W24 (part A) - until week 24, Trough concentration at steady state (part A) - until week 24.
Endpoint(s): Frexalimab plasma concentrations over time (part A) - until week 24, Pharmacokinetic parameters: Cmax (part A) - until week 24, Pharmacokinetic parameters: Tmax (part A) - until week 24, Adverse events, SAEs, AEs leading to permanent study intervention discontinuation, AESIs, and PCSAs in laboratory tests, and vital signs during the study period - until week 96., Incidence of ADAs over time (part A) - until week 96, Total number of Gd-enhancing T1 lesions at W12 and W24 (part A)., Time to onset of confirmed disability worsening (CDW)/ confirmed disability progression(CDP) confirmed over 3 months - until week 96, Medical device AEs, ADEs, SAEs, SADEs and device deficiencies throughout the study - until week 96., Percentage of participants that prefer SC administration over IV administration assessed by Items 13 and 14 of the PESQ at Week 48 completed by participants that switched from IV to SC in Part B - from week 24 to week 48., Total number of GdE T1 lesions at W48 (part B) - at week 48., Total number of GdE T1 lesions at W96 and yearly thereafter (part C) - at week 96 and yearly thereafter.

Source: https://euclinicaltrials.eu/ctis-public/view/2024-519304-28-00